EU clinical trial 2024-515287-31-00: A Randomized Double-Blind, Placebo Controlled Trial of Abatacept (CTLA4-Ig) in Giant Cell Arteritis (ABAGART)
Protocol code: VCRC5528- ABAGART
Sponsor: Trustees Of The University Of Pennsylvania (Educational Institution). Phase: Therapeutic confirmatory (Phase III). Countries: Italy (authorised, recruiting), Germany (authorised, recruiting).
Therapeutic area(s): Diseases [C] - Immune System Diseases [C20]
Gender: Female, Male. Age: 18-64 years, 65+ years. Enrolment: 16.
Status: Authorised, recruiting. Start date (EU): 2026-08-04. Decision date: 2025-07-11. Results received: No. Last updated: 2026-05-05.
Decision dates by country: IT: 2025-07-11, DE: 2025-07-11

Condition(s): Giant Cell Arteritis
Product: placebo for abatacept injection, 125 mg/syringe, Abatacept

Primary endpoint: The primary study endpoint will be the proportion of individuals in remission at Month 12 of those randomized to abatacept as compared to placebo.
Endpoint(s): Safety (adverse events/serious adverse events/SUSARs) in patients with GCA taking abatacept compared with placebo, Patient reported outcomes (Mean change from Baseline/Month 0 over time to Month 12 in SF-36, PROMIS) in patients with GCA taking abatacept compared with placebo, Median duration of glucocorticoid-free remission from Month 6 to Month 12 in patients with GCA taking abatacept compared with placebo

Source: https://euclinicaltrials.eu/ctis-public/view/2024-515287-31-00